EU clinical trial 2023-508473-86-00: ExplOratory, Phase 0 Study to assess biodisTribution and PosItron EMission Tomography (PET) Imaging kinetics of [64Cu]Cu-PSMA-R2 in metaStatic prostate cancEr patients
Protocol code: ICO-2023-25 OPTIMISE
Sponsor: Institut De Cancerologie De L Ouest (Hospital/Clinic/Other health care facility). Phase: Human Pharmacology (Phase I)- Other. Countries: France (not authorised).
Therapeutic area(s): Diseases [C] - Neoplasms [C04]
Gender: Male. Age: 18-64 years, 65+ years. Enrolment: 6.
Status: Not authorised. Decision date: 2024-09-09. Results received: No. Last updated: 2024-09-09.

Condition(s): metastatic prostate cancer

Source: https://euclinicaltrials.eu/ctis-public/view/2023-508473-86-00